EU clinical trial 2023-508212-38-00: TALTEC: A phase II study measuring MRD negativity after bispecific T-cell redirectors TALquetamab and TEClistamab consolidation as part of first line treatment in transplant eligible multiple myeloma patients
Protocol code: TALTEC JNJ-54767414
Sponsor: North Estonia Medical Centre Foundation (Hospital/Clinic/Other health care facility). Phase: Therapeutic exploratory (Phase II). Countries: Norway (ongoing, recruitment ended), Denmark (ongoing, recruitment ended), Estonia (ongoing, recruitment ended).
Therapeutic area(s): Diseases [C] - Neoplasms [C04]; Diseases [C] - Hemic and Lymphatic Diseases [C15]
Gender: Female, Male. Age: 18-64 years, 65+ years. Enrolment: 50.
Status: Ongoing, recruitment ended. Start date (EU): 2024-06-11. Decision date: 2024-03-26. Results received: No. Last updated: 2026-04-02.
Decision dates by country: DK: 2024-03-26, EE: 2024-03-27, NO: 2024-04-18

Condition(s): Multiple Myeloma
Product: DARZALEX 1800 mg solution for injection, JNJ-64407564, BORTEZOMIB, JNJ-64407564, teclistamab, LENALIDOMIDE, DEXAMETHASONE, teclistamab

Primary endpoint: MRD measured by NGS (sensitivity level of 10-6) and FDG PET-CT scan using the Deauville score and CR evaluated per IMWG 2016 response criteria after 6 cycles of talquetamab and 6 cycles of teclistamab consolidation therapy
Endpoint(s): MRD measured by NGS (sensitivity level of 10-6) and FDG PET-CT scan using the Deauville score and CR evaluated per IMWG 2016 response criteria after 6 cycles of Dara-VRd induction, Percentage of participants converting from positive MRD to negative MRD (sensitivity level of 10-6) after 6 cycles of talquetamab, Percentage of participants converting from positive MRD to negative MRD (sensitivity level of 10-6) after 6 cycles of teclistamab, Proportion of participants with persistent MRD negative disease at month 12 and 24 after completing treatment with teclistamab, by NGS (sensitivity level of 10-6), and FDG PET-CT scan, Overall Response Rate (ORR), Overall Survival (OS), Progression free survival (PFS), Duration of response (DOR), Time to next anti-myeloma treatment (TTNT), TEAEs according to the National Cancer Institute's Common Terminology Criteria for Adverse Events (NCI CTCAE, Version 5.0), Incidence of participant-recorded side effects (during the treatment with talquetamab and teclistamab) Impact of treatment on (physical, social, cognitive, emotional, overall) quality of life, MRD status 100 days after starting of standard of care treatment

Source: https://euclinicaltrials.eu/ctis-public/view/2023-508212-38-00